EU clinical trial 2024-514255-15-01: Open label, single-center pilot study to investigate enzyme replacement therapy (ERT) frequency reduction from 2 to 4 weeks in a subgroup of elderly patients with late-onset Pompe disease
Sponsor: Erasmus Universitair Medisch Centrum Rotterdam (Erasmus MC) (Hospital/Clinic/Other health care facility). Phase: Therapeutic use (Phase IV). Countries: Netherlands (ongoing, recruiting).
Therapeutic area(s): Diseases [C] - Musculoskeletal Diseases [C05]
Gender: Female, Male. Age: 18-64 years, 65+ years. Enrolment: 10.
Status: Ongoing, recruiting. Start date (EU): 2025-06-26. Decision date: 2024-11-21. Results received: No. Last updated: 2025-10-20.

Condition(s): Pompe disease
Product: Myozyme 50 mg powder for concentrate for solution for infusion, Opfolda 65 mg hard capsules, Pombiliti 105 mg powder for concentrate for solution for infusion, Nexviadyme 100 mg powder for concentrate for solution for infusion

Primary endpoint: Efficacy: - Muscle strength: manual muscle testing (MMT), hand-held dynamometry (HHD) - Muscle function: 6-minute walk test (6MWT), quick motor function test (QMFT) - Pulmonary function: forced vital capacity (FVC) in sitting and supine position, maximum inspiratory pressure (MIP), maximum expiratory pressure (MEP) - Patient reported outcome measures (PROMs): modified Rasch-built Pompe-specific activity (mR-PAct) scale, SF-36 (QoL, quality of life), Safety: - Vital signs: heart rate, blood pressure, respiratory rate - Weight - Assessment of treatment-emergent adverse events (TEAEs), including infusion associated reactions (IARs)

Source: https://euclinicaltrials.eu/ctis-public/view/2024-514255-15-01